EU clinical trial 2025-524873-17-00: A Phase 3, Double-blinded, Vehicle-controlled Trial to Investigate the Efficacy and Safety of Twice-daily Delgocitinib Cream in Adult Participants with Lichen Sclerosus During a 12-Week Initial Treatment Period Followed by a 40-Week Continuation Treatment Period
Protocol code: LP0133-2395
Sponsor: Leo Pharma A/S (Pharmaceutical company). Phase: Therapeutic confirmatory (Phase III). Countries: Italy (authorised, recruitment pending), France (authorised, recruitment pending), Spain (authorised, recruitment pending), Poland (authorised, recruitment pending), Germany (authorised, recruitment pending).
Therapeutic area(s): Diseases [C] - Skin and Connective Tissue Diseases [C17]
Gender: Female, Male. Age: 18-64 years, 65+ years. Enrolment: 205.
Status: Authorised, recruitment pending. Decision date: 2026-07-21. Results received: No. Last updated: 2026-07-24.
Decision dates by country: FR: 2026-07-24, IT: 2026-07-23, ES: 2026-07-24, PL: 2026-07-23, DE: 2026-07-21

Condition(s): Lichen Sclerosus
Product: Cream Vehicle, Delgocitinib cream 8 mg/g, Delgocitinib cream

Primary endpoint: Achieving IGA-LS TS at Week 12.
Endpoint(s): 1) Achieving IGA-LS TS at Week 8., 2) Change in CLISSCO score from baseline to Week 12., 3) Achieving a reduction of skin pain NRS score (weekly average) of ≥4 points from baseline to Week 12 in participants with baseline skin pain NRS score ≥4., 4) Achieving a reduction of skin pain NRS score (weekly average) of ≥4 points from baseline to Week 8 in participants with baseline skin pain NRS score ≥4., 5) Achieving a reduction of itch NRS score (weekly average) of ≥4 points from baseline to Week 12 in participants with baseline itch NRS score ≥4., 6) Change in VQLI score from baseline to Week 12., 7) Achieving IGA-LS TS at Week 52., 8) Change in CLISSCO score from baseline to Week 52., 9) Achieving IGA-LS TS at Week 52 among participants having achieved IGA-LS TS at Week 12., 10) Achieving an IGA-LS score of 0 or 1 at Week 52 among participants having achieved IGA-LS TS at Week 12., 11) Time to IGA-LS TS (from baseline to Week 52)., 12) Time to IGA-LS ≥2 (from Week 12 to Week 52) among participants having achieved IGA-LS TS at Week 12., 13) Having no increase in CLISSCO architectural changes domain score from baseline to Week 52., 14) Achieving a reduction of skin pain NRS score (weekly average) of ≥4 points (from baseline to Week 52) in participants with baseline skin pain NRS score ≥4., 15) Achieving a reduction of itch NRS score (weekly average) of ≥4 points (from baseline to Week 52) in participants with baseline itch NRS score ≥4., 16) Number of treatment-emergent AEs from baseline to Week 12., 17) Number of treatment-emergent AEs from Week 12 to Week 54.

Source: https://euclinicaltrials.eu/ctis-public/view/2025-524873-17-00